EU clinical trial 2023-507556-68-00: A two-year, double-blind, randomized, multicenter, active controlled Core Phase study to evaluate the safety and efficacy of fingolimod administered orally once daily versus interferon β-1a i.m. once weekly in pediatric patients with multiple sclerosis with five-year fingolimod Extension Phase
Protocol code: CFTY720D2311
Sponsor: Novartis Pharma AG (Pharmaceutical company). Phase: Therapeutic confirmatory (Phase III). Countries: Germany (ongoing, recruitment ended), France (ongoing, recruitment ended), Slovakia (ongoing, recruitment ended), Spain (ended), Romania (ongoing, recruitment ended).
Therapeutic area(s): Diseases [C] - Nervous System Diseases [C10]
Gender: Female, Male. Age: 0-17 years. Enrolment: 35.
Start date (EU): 2013-07-26. Decision date: 2024-04-04. Results received: No. Last updated: 2026-04-02.
Decision dates by country: SK: 2024-04-04, FR: 2024-04-04, DE: 2024-04-08, RO: 2024-04-09, ES: 2024-04-08

Condition(s): Multiple Sclerosis
Product: Gilenya 0.5 mg hard capsules, Gilenya 0.25 mg hard capsules

Primary endpoint: Annualized relapse rate (ARR) and time to relapse, The annualized rate of new/newly enlarged T2 lesion, Patients free of new or newly enlarged T2 lesions
Endpoint(s): The number of Gd-enhanced T1 lesions, Patients free of Gd-enhanced T1 lesions, Number of CUA lesions, Change from baseline in T2 lesion/ T1 hypointense lesion volume, Percent brain volume change

Source: https://euclinicaltrials.eu/ctis-public/view/2023-507556-68-00